EU clinical trial 2024-520119-41-00: VEMURAFENIB PLUS RITUXIMAB AS A CHEMOTHERAPY-FREE ALTERNATIVE TO CLADRIBINE FOLLOWED BY MRD-GUIDED RITUXIMAB IN FRONT-LINE HAIRY CELL LEUKEMIA (HCL): A PHASE-2 RANDOMIZED MULTICENTER TRIAL
Sponsor: Universita' Degli Studi Di Perugia (Educational Institution). Phase: Therapeutic exploratory (Phase II). Countries: Italy (ongoing, recruiting).
Therapeutic area(s): Diseases [C] - Neoplasms [C04]
Gender: Female, Male. Age: 18-64 years, 65+ years. Enrolment: 120.
Status: Ongoing, recruiting. Start date (EU): 2023-01-15. Decision date: 2025-01-27. Results received: No. Last updated: 2026-02-24.

Condition(s): Previously untreated patients with diagnosis of HCL
Product: Zelboraf 240 mg film-coated tablets, MabThera 100 mg concentrate for solution for infusion, MabThera 500 mg concentrate for solution for infusion, LITAK 2 mg/ml solution for injection

Primary endpoint: The primary efficacy endpoint is the rate of complete remission (CR) at ~6 months after treatment initiation (VR or monotherapy with CDA) in randomized patients, adjudication of the primary endpoint will be centrally performed by an external independent committee unaware of treatment assignments., The primary safety endpoint is the proportion of randomized patients experiencing =1 drug-related toxicity of maximum grade =3 according to the Common Terminology Criteria for Adverse Events (CTCAE), version 5.0 that occurs within 6 months from starting treatment (VR or monotherapy with CDA) as reported by the investigators and that is at least possibly related to the study drugs.
Endpoint(s): Time from starting treatment until resolution of cytopenias, Proportion of patients clearing measurable/minimal residual disease (MRD) by PCR and/or flow cytometry and/or immunohistochemistry in bone marrow and blood cell samples, as well as by PCR in the plasma (liquid biopsy)., Survival free from MRD (calculated in patients clearing MRD from the time of MRD clearing)., Time from starting treatment until recovery of CD4+ T cells, CD8+ T cells, B cells and NK cells recovery to normal values., Survival free from relapse (calculated in patients obtaining a OR from the time of OR achievement)., Survival free from disease progression (calculated in all patients since starting treatment)., Survival free from a subsequent anti-leukemic treatment (calculated in patients undergoing a new treatment from the end of trial therapy)., Survival free from death (calculated in all patients since starting treatment), Treatment-related toxicities (total counts and proportion of patients affected) separately grouped in grade 3, grade 4 or grade 5, by central assessment., Treatment-related toxicities (total counts and proportion of patients affected) separately grouped in grade 3, grade 4 or grade 5, by local assessment., Adverse events and toxicities of any grades (total counts and proportion of patients affected), by local assessment., Role of PET-CT in HCL staging and response to therapy., Quality of life, as quantified through ad hoc questionnaire., Pharmaco-economic analysis of global treatment costs., In patients enrolled but not randomized due to concern(s) against the standard and/or experimental treatment (including, but not limited to, active severe infection or risk thereof, including risk of severe Covid19 in unvaccinated patients; renal or hepatic impairment; severe QTc prolongation; history of an aggressive cancer type frequently associated with RAS mutations that was unlikely eradicated, lack of the BRAF-V600E mutation; etc.), prospective evaluation of the efficacy and safety of any, Proportion of patients in the control arm that reach a CR with sequential rituximab among patients not achieving CR after CDA monotherapy.

Source: https://euclinicaltrials.eu/ctis-public/view/2024-520119-41-00